EU clinical trial 2024-514963-24-00: Daratumumab combined with Bortezomib, Cyclophosphamide and Dexamethasone for the Treatment of Multiple Myeloma Patients Presenting with Extramedullary Disease
Protocol code: EMN19
Sponsor: European Myeloma Network B.V., Emn Trial Office S.r.l. Impresa Sociale (Patient organisation/association, Laboratory/Research/Testing facility). Phase: Therapeutic exploratory (Phase II). Countries: Greece (ongoing, recruitment ended), Italy (ongoing, recruitment ended).
Therapeutic area(s): Diseases [C] - Hemic and Lymphatic Diseases [C15]
Gender: Female, Male. Age: 18-64 years, 65+ years. Enrolment: 11.
Status: Ongoing, recruitment ended. Start date (EU): 2020-02-04. Decision date: 2024-09-16. Results received: No. Last updated: 2026-05-11.
Decision dates by country: GR: 2024-09-20, IT: 2024-09-16

Condition(s): Multiple Myeloma patients presenting with extramedullary disease
Product: DARZALEX 1800 mg solution for injection, VELCADE 3.5 mg powder for solution for injection, CYCLOPHOSPHAMIDE, DEXAMETHASONE

Primary endpoint: Proportion of patients with CR
Endpoint(s): Duration of Response (DoR), Progression Free Survival (PFS), Overall Response Rate (ORR), Time To next Therapy (TnT), Overall Survival (OS), Safety (adverse events)

Source: https://euclinicaltrials.eu/ctis-public/view/2024-514963-24-00